EU clinical trial 2025-520490-38-00: A research study looking at how different doses of study medicine (Inno8) work in the body of people with haemophilia A
Protocol code: NN7442-8454
Sponsor: Novo Nordisk A/S (Pharmaceutical company). Phase: Human Pharmacology (Phase I)- Other. Countries: Poland (ongoing, recruiting), Spain (ongoing, recruiting), Austria (ongoing, recruiting), Italy (ongoing, recruiting), Germany (ongoing, recruiting), Belgium (authorised, recruitment pending), France (ongoing, recruiting), Portugal (ongoing, recruiting), Sweden (ongoing, recruiting).
Therapeutic area(s): Diseases [C] - Congenital, Hereditary, and Neonatal Diseases and Abnormalities [C16]
Gender: Male. Age: 18-64 years. Enrolment: 28.
Start date (EU): 2025-10-13. Decision date: 2025-09-22. Results received: No. Last updated: 2026-06-22.
Decision dates by country: IT: 2025-09-24, AT: 2025-09-22, BE: 2026-06-22, FR: 2026-06-12, PT: 2026-05-28, SE: 2026-05-29, PL: 2025-09-27, DE: 2025-09-26, ES: 2025-09-26

Condition(s): Haemophilia A with or without inhibitors. Proposed indication under development: prevention of bleeding and long-term prophylaxis in patients with haemophilia A, irrespective of inhibitor status or severity.

Source: https://euclinicaltrials.eu/ctis-public/view/2025-520490-38-00